EU clinical trial 2023-510336-36-00: An Open-Label Extension Study to Evaluate the Long-Term Safety, Tolerability, and Efficacy of Pozelimab and Cemdisiran Combination Therapy in Patients with Paroxysmal Nocturnal Hemoglobinuria
Protocol code: R3918-PNH-2050
Sponsor: Regeneron Pharmaceuticals Inc. (Pharmaceutical company). Phase: Therapeutic confirmatory (Phase III). Countries: Spain (ongoing, recruitment ended), Romania (ongoing, recruitment ended), Italy (ongoing, recruitment ended), Hungary (ongoing, recruitment ended), Greece (ended), Poland (ongoing, recruitment ended).
Therapeutic area(s): Diseases [C] - Hemic and Lymphatic Diseases [C15]
Gender: Female, Male. Age: 18-64 years, 65+ years. Enrolment: 17.
Start date (EU): 2023-05-05. Decision date: 2024-11-27. Results received: No. Last updated: 2026-07-08.
Decision dates by country: GR: 2024-12-09, IT: 2024-12-03, HU: 2024-11-29, RO: 2024-12-20, ES: 2024-11-27, PL: 2024-12-13

Condition(s): Paroxysmal nocturnal hemoglobinuria (PNH)
Product: Pozelimab, Cemdisiran

Primary endpoint: Incidence of treatment-emergent serious adverse events (SAEs), Severity of treatment-emergent SAEs, Incidence of treatment emergent adverse events of special interest (AESIs), Severity of treatment emergent AESIs, Incidence of adverse events (AEs) leading to permanent treatment discontinuation, Severity of adverse events (AEs) leading to permanent treatment discontinuation, Percent change from baseline in lactate dehydrogenase (LDH)
Endpoint(s): Adequate control of hemolysis (LDH ≤1.5 × ULN), Transfusion avoidance, Breakthrough hemolysis (defined as LDH ≥2 × ULN [subsequent to initial achievement of LDH ≤1.5 × ULN] concomitant with signs or symptoms associated with hemolysis), Hemoglobin stabilization, Percent change in LDH, Change in fatigue, Change in physical function (PF) scores on the EORTC QLQ-C30, Change in GHS/quality of life (QOL) scale on the EORTC QLQ-C30, Normalization of LDH, Rate of red blood cell (RBC) transfusion, Number of units of RBC transfusion, Percentage of days with LDH ≤1.5x upper limit of normal (ULN), Change in hemoglobin levels, Change in total complement hemolytic activity assay (CH50), Percent change in CH50, Concentrations of total pozelimab in serum, Concentrations of cemdisiran in plasma, Incidence of treatment-emergent anti-drug antibodies to pozelimab, Incidence of treatment-emergent anti-drug antibodies to cemdisiran, Concentration of total complement component 5 (C5) in plasma, Percent change of concentration of total C5 in plasma

Source: https://euclinicaltrials.eu/ctis-public/view/2023-510336-36-00